EU clinical trial 2024-514497-41-00: A Phase II/III, multicentre, 8-week run-in phase followed by a 12- week, prospective, parallel-group, double-blind, randomized withdrawal, placebo-controlled study, with a 52 week open label extension, to evaluate the efficacy and safety of daily 1.5 to 3.5 mg basimglurant in patients with pain associated with trigeminal neuralgia with suboptimal response to their current anti-pain therapy
Protocol code: NOE-TGN-201
Sponsor: Noema Pharma AG (Pharmaceutical company). Phase: Phase II and Phase III (Integrated). Countries: Italy (ongoing, recruitment ended), Germany (ended), Denmark (ended), Poland (ongoing, recruitment ended), Spain (ended).
Therapeutic area(s): Diseases [C] - Nervous System Diseases [C10]
Gender: Female, Male. Age: 18-64 years, 65+ years. Enrolment: 111.
Start date (EU): 2022-03-24. Decision date: 2024-10-18. Results received: No. Last updated: 2026-03-17.
Decision dates by country: DK: 2024-10-23, DE: 2024-10-18, ES: 2024-10-18, IT: 2024-10-28, PL: 2024-11-08

Condition(s): Trigeminal neuralgia, Trigeminal neuralgia
Product: Placebo to Basimglurant (Microcrystalline Cellulose Spheres (Vivapur 1000) and hard Gelatin Capsule, Opaque white body/Opaque white cap, Size 1), Basimglurant, Basimglurant

Primary endpoint: Period 1: Run-in: Change in pain as measured by the pain diary (TnED). Incidence and severity of AEs. Laboratory, vital signs and cardiovascular safety will also be evaluated. Changes in psychiatric status as measured by the BPRS. Treatment emergent suicidal ideation and behavior as measured by the S-STS., Period 2: Double Blind: Time to Loss of Efficacy for each participant as determined by the IAC., Open-Label Extension: Incidence and severity of AEs. Laboratory, vital signs and cardiovascular safety will also be evaluated. Changes in psychiatric status as measured by the BPRS. Treatment emergent suicidal ideation and behavior as measured by the S-STS.
Endpoint(s): Period 1: Run-in: • Proportion of pain free days as measured by TnED. • Number and severity of attacks (paroxysms) as well as duration and severity of continuous pain compared with BL1, as measured by TnED • Changes in pain interference with daily activities compared to BL1, as measured by TnED • Mean change from BL1 to Week 8 in the total patient-rated PENN-FPS-R • PGI-C from BL1 to Week 8 • Patient reported rating of the MSQ. • Changes from BL1 to Week 8 in SDS, Period 2: Double Blind: • Proportion of pain free days as measured by TnED in the double-blind randomized withdrawal period until end of double-blind randomized treatment or start of pain rescue medication intake. • Number and severity of attacks (paroxysms) as well as severity and duration of continuous pain, as measured by TnED, • Changes in pain interference with daily activities compared to BL2, as measured by TnED, '• Change at the end of double-blind randomized treatment or start of rescue medication intake during the double-blind randomized withdrawal period in the total patient-rated PENN-FPS-R compared with BL2 • PGI-C at the end of double-blind randomized treatment or start of rescue medication intake during the double-blind randomized withdrawal period • Patient reported rating of the MSQ, '• Incidence and severity of AEs. Laboratory and cardiovascular safety will also be evaluated. Changes in psychiatric status as measured by the BPRS. Treatment emergent suicidal ideation and behavior as measured by the S-STS., 'Open-Label Extension: • Proportion of pain free days as measured by TnED. • Number and severity of attacks (paroxysms) as well as severity and duration of continuous pain, as measured by TnED. • Pain interference with daily activities, as measured by TnED. • Mean scores in the total patient-rated PENN-FPSR. • Overall patient global impression measured by the PGI-S.

Source: https://euclinicaltrials.eu/ctis-public/view/2024-514497-41-00